EU clinical trial 2024-518420-80-00: A Multicenter, Randomized, Controlled, Open-label, Group-Sequential, Phase 3 Study to Investigate the Efficacy, Safety, and Tolerability of Intravenous Gammagard Liquid (Immune Globulin Infusion, 10%) for Primary Infection Prophylaxis Compared With Secondary Infection Prophylaxis in Adult Subjects With Multiple Myeloma Receiving B-Cell Maturation Antigen×CD3–Directed Bispecific Antibody Therapy
Protocol code: TAK-339-3001
Sponsor: Takeda Development Center Americas Inc. (Pharmaceutical company). Phase: Therapeutic confirmatory (Phase III). Countries: Hungary (ongoing, recruiting), Germany (authorised, recruitment pending), Greece (ongoing, recruiting), Netherlands (ongoing, recruiting), Austria (ongoing, recruiting), Poland (ongoing, recruiting), Italy (ongoing, recruiting), Czechia (ongoing, recruiting), Spain (ongoing, recruiting), Denmark (ongoing, recruiting), Romania (ongoing, recruiting), Norway (ongoing, recruiting).
Therapeutic area(s): Diseases [C] - Immune System Diseases [C20]
Gender: Female, Male. Age: 18-64 years, 65+ years. Enrolment: 172.
Start date (EU): 2026-02-24. Decision date: 2025-08-25. Results received: No. Last updated: 2026-05-06.
Decision dates by country: ES: 2025-08-28, AT: 2025-08-31, CZ: 2025-08-26, DE: 2025-09-01, NL: 2025-08-25, DK: 2025-08-26, HU: 2025-08-28, PL: 2025-09-01, IT: 2025-08-27, GR: 2025-08-26, RO: 2026-04-30, NO: 2026-05-06

Condition(s): Primary infection prophylaxis for secondary immunodeficiency (SID) in patients with multiple myeloma (MM) receiving B cell maturation antigen (BCMA)-directed bispecific (BsAb) therapy
Product: KIOVIG 100 mg/ml solution for infusion, TECVAYLI 90 mg/mL solution for injection, TECVAYLI 10 mg/mL solution for injection, KIOVIG 100 mg/ml solution for infusion

Primary endpoint: Time to the first serious infection.
Endpoint(s): 1. Occurrence of at least 1 serious infection during the observational period of 12 months., 2. Annualized rate of days on antibiotics (for treatment of bacterial infections)., 3. Annualized rate of bacterial infections.

Source: https://euclinicaltrials.eu/ctis-public/view/2024-518420-80-00